EU clinical trial 2024-514330-20-00: A single-center, self-controlled, single-arm pilot clinical trial to assess the effect of lamivudine (3TC) on neurocognitive impairment biomarkers and type-I IFN (interferon)-stimulated genes in the plasma of patients with Mild Cognitive Impairment (MCI)
Protocol code: LAMIFERON
Sponsor: Fundacion Fls De Lucha Contra El Sida Las Enfermedades Infecciosas Y La Promocion De La Salud Y La Ciencia (Patient organisation/association). Phase: Therapeutic exploratory (Phase II). Countries: Spain (ended).
Therapeutic area(s): Diseases [C] - Nervous System Diseases [C10]
Gender: Female, Male. Age: 18-64 years, 65+ years. Enrolment: 25.
Status: Ended. Start date (EU): 2024-10-25. End date (EU): 2026-02-18. Decision date: 2024-07-31. Results received: No. Last updated: 2024-07-31.

Condition(s): Mild Cognitive impairment due to Alzheimer Disease
Product: Lamivudina Aurovitas 300 mg comprimidos recubiertos con película EFG

Primary endpoint: Percentage of change of pTau-217, total Tau, NfL, GFAP, Aβ42, Aβ40, and ratio in plasma from baseline visit to week 24 visit. Safety and tolerability as measured by incidence, nature, and severity of treatment adverse events (AE), serious AE (SAE), and AE leading to withdrawal.
Endpoint(s): Fold change of type-I IFN-stimulated genes in plasma and cryopreserved PBMCs from baseline visit to week 24 visit.

Source: https://euclinicaltrials.eu/ctis-public/view/2024-514330-20-00